EU clinical trial 2025-521809-40-00: A phase I Study to Assess the Safety and Tolerability of MBF-362 in Healthy Women, and Preliminary Efficacy in Otherwise Healthy Women diagnosed with Primary Dysmenorrhea
Protocol code: MBF-362CT-02
Sponsor: Medibiofarma S.L. (Pharmaceutical company). Phase: Human Pharmacology (Phase I)- Other. Countries: Spain (ongoing, recruiting).
Therapeutic area(s): Diseases [C] - Female Urogenital Diseases and Pregnancy Complications [C13]
Gender: Female. Age: 18-64 years. Enrolment: 24.
Status: Ongoing, recruiting. Start date (EU): 2025-12-10. Decision date: 2025-08-12. Results received: No. Last updated: 2025-12-01.

Condition(s): Primary Dysmenorrhea

Source: https://euclinicaltrials.eu/ctis-public/view/2025-521809-40-00